EU clinical trial 2023-507144-36-00: A Phase 3 Multicenter, Open-label Study to Evaluate the Efficacy, Pharmacokinetics, Safety, and Immunogenicity of Subcutaneously Administered Ustekinumab or Guselkumab in Pediatric Participants With Active Juvenile Psoriatic Arthritis (PSUMMIT-Jr)
Protocol code: CNTO1275JPA3001
Sponsor: Janssen - Cilag International (Pharmaceutical company). Phase: Therapeutic confirmatory (Phase III). Countries: France (ended), Poland (ended), Netherlands (ended), Spain (ended), Germany (ended), Denmark (ended), Italy (ended).
Therapeutic area(s): Diseases [C] - Skin and Connective Tissue Diseases [C17]
Gender: Female, Male. Age: 0-17 years. Enrolment: 28.
Status: Ended. Start date (EU): 2023-04-20. End date (EU): 2026-05-26. Decision date: 2024-07-17. Results received: No. Last updated: 2026-02-02.
Decision dates by country: DK: 2024-07-21, IT: 2024-07-22, NL: 2024-07-17, FR: 2024-07-17, DE: 2024-07-19, ES: 2024-07-17, PL: 2024-07-17

Condition(s): Juvenile psoriatic arthritis
Product: STELARA 90 mg solution for injection in pre-filled syringe, Guselkumab, STELARA 45 mg solution for injection, Guselkumab - solution for injection in pre-filled syringe - 100 mg/mL

Primary endpoint: Ustekinumab Steady-state trough concentrations and population PK model-predicted AUCss over a 12-week dosing interval at Week 28 by baseline age groups., Ustekinumab ACR Pedi 30 response at Week 24., Guselkumab Steady-state trough concentrations and population PK model-predicted AUCss over a dosing interval (4 or 8 weeks) at Week 28 by baseline age groups., Guselkumab ACR Pedi 30 response at Week 24.
Endpoint(s): PK – Ustekinumab Steady-state trough concentrations and population PK model-predicted AUCss over a 12-week dosing interval at Week 52 by baseline age groups, PK – Guselkumab Steady-state trough concentrations and population PK model-predicted AUCss over a dosing interval (4 or 8 weeks) at Week 52 by baseline age groups., Efficacy – Ustekinumab ACR Pedi 30 response at Weeks 4, 8, 12, 16, and 52., Efficacy – Ustekinumab ACR Pedi 50 and 70 responses at Weeks 4, 8, 12, 16, 24, and 52., Efficacy – Ustekinumab Time to response measured as time to achieving ACR Pedi 30 from baseline through Week 24., Efficacy – Ustekinumab Change from baseline in cJADAS 10, JADAS 10, 27, and 71 at Weeks 4, 8, 12, 16, 24, and 52., Efficacy – Ustekinumab Change from baseline in PASI score at Week 24 among the participants with ≥3% BSA psoriatic involvement and a PGA psoriasis score of ≥2 (mild) at baseline., Efficacy – Guselkumab ACR Pedi 30 response at Weeks 4, 8, 12, 16, and 52., Efficacy – Guselkumab ACR Pedi 50 and 70 responses at Weeks 4, 8, 12, 16, 24, and 52., Efficacy – Guselkumab Time to response measured as time to achieving ACR Pedi 30 from baseline through Week 24., Efficacy – Guselkumab Change from baseline in cJADAS 10, JADAS 10, 27, and 71 at Weeks 4, 8, 12, 16, 24, and 52., Efficacy – Guselkumab Change from baseline in PASI score at Week 24 among the participants with ≥3% BSA psoriatic involvement and a PGA psoriasis score of ≥2 (mild) at baseline., Safety – Ustekinumab The occurrences and type of AEs, SAEs, and reasonably related AEs., Safety –Guselkumab The occurrences and type of AEs, SAEs, and reasonably related AEs., Immunogenicity – Ustekinumab The incidence of antibodies to ustekinumab/guselkumab (including peak titers) through Week 52 and Week 68., Immunogenicity –Guselkumab The incidence of antibodies to ustekinumab/guselkumab (including peak titers) through Week 52 and Week 68.

Source: https://euclinicaltrials.eu/ctis-public/view/2023-507144-36-00